EU clinical trial 2024-512473-27-00: Phase II study to assess in vivo imaging of MMR-expressing macrophages in cardiac sarcoidosis using 68Ga-NOTA-Anti-MMR-VHH2 Positron Emission Tomography (PET).
Protocol code: BW_M2-Target
Sponsor: Cliniques Universitaires Saint-Luc (Hospital/Clinic/Other health care facility). Phase: Therapeutic exploratory (Phase II). Countries: Belgium (authorised, recruitment pending).
Therapeutic area(s): Diseases [C] - Cardiovascular Diseases [C14]
Gender: Female, Male. Age: 18-64 years, 65+ years. Enrolment: 15.
Status: Authorised, recruitment pending. Decision date: 2024-09-25. Results received: No. Last updated: 2024-09-25.

Condition(s): Cardiac sarcoidosis
Product: 68Ga-UZBRU-VHH2

Primary endpoint: Proportion of patients with (historical) histological proven or clinical ‘probable’ diagnosis of cardiac sarcoidosis (defined by HRS 2024 consensus recommendations) confirmed by 68Ga-NOTA-Anti- MMR-VHH2 (defined as focal/patchy uptake pattern of 68Ga-NOTA-Anti-MMR-VHH2 above background activity consistent with sarcoid involvement).
Endpoint(s): Incidence rate of all adverse events (AEs) and serious AEs (SAEs) detected during the study procedures., Comparison of semi-quantitative PET indices (SUVmax and Target-to-background ratio) between 68Ga-NOTA-Anti-MMR-VHH2 and FDG-PET/CT patients with cardiac sarcoidosis., Proportion of patients with confirmed 68Ga-NOTA-Anti-MMR-VHH2 uptake (defined as 68Ga-NOTA-Anti-MMR-VHH2uptake above background activity) in sarcoidosisrelated lesions compared to LGE lesions on cardiac MRI., Proportion of patients with confirmed 68Ga-NOTA-Anti-MMR-VHH2 uptake (defined as 68Ga-NOTA-Anti-MMR-VHH2uptake above background activity) in sarcoidosisrelated lesions is compared to histologically confirmed presence of M2 macrophages (if available)., Proportion of patients with decreased or normalized of 68Ga-NOTA-Anti-MMR-VHH2 uptake (representing presence of MMR expressing macrophages) in sarcoidosisrelated lesions after CS treatment compared to FDG PET/CT and cMRI., Proportion of patients with anti-drug antibodies (ADA) against 68Ga-NOTA-Anti- MMR-VHH2.

Source: https://euclinicaltrials.eu/ctis-public/view/2024-512473-27-00